EU clinical trial 2023-507171-22-00: A Phase Ib/II, Open-Label, Multicenter Study Evaluating the Safety, Activity, and Pharmacokinetics of Divarasib as a Single Agent or in Combination with Other Anti-Cancer Therapies in Patients with Previously Untreated Advanced or Metastatic Non-Small Cell Lung Cancer with a KRAS G12C Mutation
Protocol code: BO44426
Sponsor: F. Hoffmann-La Roche AG (Pharmaceutical company). Phase: Phase I and Phase II (Integrated)- Other. Countries: Netherlands (ongoing, recruiting), Sweden (ongoing, recruiting), Poland (ongoing, recruiting), Spain (ongoing, recruiting), Belgium (ongoing, recruiting), Italy (ongoing, recruiting).
Therapeutic area(s): Diseases [C] - Neoplasms [C04]
Gender: Female, Male. Age: 18-64 years, 65+ years. Enrolment: 116.
Status: Ongoing, recruiting. Start date (EU): 2023-06-21. Decision date: 2024-05-27. Results received: No. Last updated: 2026-06-05.
Decision dates by country: SE: 2024-05-28, PL: 2024-06-10, BE: 2024-06-03, ES: 2024-06-04, NL: 2024-05-27, IT: 2024-06-03

Condition(s): Untreated Advanced or Metastatic Non-Small Cell Lung Cancer
Product: ALIMTA 500 mg powder for concentrate for solution for infusion, CARBOPLATINE ACCORD 10 mg/ml, solution pour perfusion, Cisplatin Teva® 1 mg/ml Konzentrat zur Herstellung einer Infusionslösung, Pemetrexed Accord 25 mg/ml concentrate for solution for infusion, RO 743-5846/F04, RO 743-5846/F06, ALIMTA 100 mg powder for concentrate for solution for infusion, RO 743-5846/F07, CARBO-cell® 10 mg/ml Infusionslösung, Konzentrat zur Herstellung einer Infusionslösung, Budenofalk 3mg magensaftresistente Hartkapseln, KEYTRUDA 25 mg/mL concentrate for solution for infusion, Pemetrexed Fresenius Kabi 25 mg/ml concentrate for solution for infusion, PEMETREXED, Carboplatin-GRY® 10 mg/ml Konzentrat zur Herstellung einer Infusionslösung, CISPLATINE ACCORD 1 mg/ml, solution à diluer pour perfusion, PEMETREXED, KEYTRUDA 25 mg/mL concentrate for solution for infusion., Cisplatin NeoCorp 1 mg/ml - Konzentrat zur Herstellung einer Infusionslösung

Primary endpoint: 1. Occurrence of adverse events, 2. Change from baseline at each visit in targeted safety parameters
Endpoint(s): 1. Objective response rate, 2. Duration of response, 3. Progression free survival, 4. CNS response defined as the percentage of participants who experience a complete response or partial response in the brain, as determined by the investigator according to modified RECIST (Cohort D Only), 5. Change from baseline in symptomatic side effects, as assessed through use of the PRO-CTCAE, 6. Proportion of participants reporting "frequent" or "almost constant" diarrhea during the first three cycles of treatment according to the PRO-CTCAE criteria, 7. Proportion of participants reporting "severe" or "very severe" nausea or vomiting during the first three cycles of treatment according to the PRO-CTCAE, 8. Frequency of participant's response of the degree they are troubled with treatment symptoms, as assessed through use of the single-item European Organisation for Research and Treatment of Cancer (EORTC) Item List 46 (IL46), 9. Plasma concentration of divarasib at specified timepoints, 10. Recommended dose of divarasib in combination with pembrolizumab (Cohort A) or pembrolizumab plus platinum-based chemotherapy and pemetrexed (Cohort B) based on the totality of safety, activity, and PK data, 11. Presence, frequency of occurrence, severity, and/or degree of interference with daily function of symptomatic side effects as assessed through use of the Patient-Reported Outcomes Common Terminology Criteria for Adverse Events (PRO‑CTCAE)

Source: https://euclinicaltrials.eu/ctis-public/view/2023-507171-22-00